EU clinical trial 2024-512332-29-00: A study to test whether BI 456906 (survodutide) influences the amount of bupropion, caffeine and midazolam in the blood in people with overweight or obesity
Protocol code: 1404-0008
Sponsor: Boehringer Ingelheim International GmbH (Pharmaceutical company). Phase: Human Pharmacology (Phase I)- Other. Countries: Belgium (ended).
Therapeutic area(s): Diseases [C] - Nutritional and Metabolic Diseases [C18]
Gender: Female, Male. Age: 18-64 years. Enrolment: 30.
Status: Ended. Start date (EU): 2024-09-05. End date (EU): 2026-01-05. Decision date: 2024-08-05. Results received: No. Last updated: 2025-10-23.

Condition(s): Overweight, Obesity

Source: https://euclinicaltrials.eu/ctis-public/view/2024-512332-29-00